EU clinical trial 2024-520076-10-01: Targeting inflammation in depression using Minocycline: a patient stratification approach using peripheral inflammatory biomarkers and MRI
Protocol code: 2020-005162-33
Sponsor: Provincia Lombardo Veneta Dell’Ordine Ospedaliero Di San Giovanni Di Dio Fatebenefratelli (Hospital/Clinic/Other health care facility). Phase: Therapeutic exploratory (Phase II). Countries: Italy (authorised, recruitment pending).
Therapeutic area(s): Diseases [C] - Nervous System Diseases [C10]; Psychiatry and Psychology [F] - Mental Disorders [F03]
Gender: Female, Male. Age: 18-64 years, 65+ years. Enrolment: 100.
Status: Authorised, recruitment pending. Decision date: 2025-02-03. Results received: No. Last updated: 2026-02-04.

Condition(s): Depression
Product: MINOCIN 100 mg capsule rigide

Primary endpoint: Changes in the levels of peripheral inflammatory biomarkers in depressed patients before and after 8 weeks of treatment with Minocycline.
Endpoint(s): Changes in depressive symptoms in depressed patients before and after 8 weeks of treatment with Minocycline, Structural and functional brain changes before and after 8 weeks of treatment with Minocycline, Associations among changes in MRI, peripheral inflammation and any improvement in depressive symptoms, Changes in depressive symptoms and in the levels of peripheral pro-inflammatory cytokines at 12 and 32 weeks from baseline, such as 4 and 24 weeks after completing the 8-week treatment period;

Source: https://euclinicaltrials.eu/ctis-public/view/2024-520076-10-01